EU clinical trial 2023-504414-29-00: Observational Study to Evaluate Efficacy, Safety and Biomarkers of Bulevirtide Treatment in Patients with Chronic hepatitis D
Protocol code: SEE-D
Sponsor: Karolinska University Hospital (Hospital/Clinic/Other health care facility). Phase: Phase III and phase IV (Integrated). Countries: Sweden (ongoing, recruiting).
Therapeutic area(s): Diseases [C] - Virus Diseases [C02]
Gender: Female, Male. Age: 18-64 years, 65+ years. Enrolment: 400.
Status: Ongoing, recruiting. Start date (EU): 2023-06-19. Decision date: 2023-05-12. Results received: No. Last updated: 2023-05-12.

Condition(s): hepatitis D
Product: Pegasys 135 micrograms solution for injection in pre-filled syringe, Pegasys 180 micrograms solution for injection in pre-filled syringe, Baraclude 1 mg film-coated tablets, Baraclude 0.5 mg film-coated tablets, Vemlidy 25 mg film-coated tablets., Viread 245 mg film-coated tablets, HEPCLUDEX 2 mg powder for solution for injection

Primary endpoint: Percentage of patients with virological response of HDV RNA < LoD at FU 12 months after EOT.
Endpoint(s): Percentage of patients with virological response of HDV RNA < LoD at month 1, 3 and every 3 months during treatment, and FU month 3, 6 and 9 after EOT., Percentage of patients with HBsAg < LoD at month 1 and 3, and every 3 months after treatment start, and FU month 3, 6, 9 and 12 after EOT., Change of HBsAg from baseline every 3 months during study period., Percentage of patients with HDV RNA < LoD or HDV RNA reduction of at least 2 log10 compared to baseline, at month 1 and 3, and every 3 months after treatment start, and FU month 3, 6, 9 and 12 after EOT., Percentage of patients with virological relapse, defined as HDV RNA < LoD at EOT and increase of HDV RNA to > LoD after EOT, after EOT, at FU month 3, 6, 9 and 12 after EOT., Percentage of patients with appearance of hepatitis B surface antibody (anti-HBs) at EOT, and FU month 3, 6, 9 and 12 after EOT., Percentage of patients with HBV DNA level < LoD every 3 months during study period., Percentage of patients with biochemical response, defined as normalization of alanine transaminase (ALT), at month 1, 3 and every 3 months during treatment, and FU month 3, 6, 9 and 12 after EOT., Percentage of patients with combined response, defined as HDV RNA < LoD or HDV RNA reduction of at least 2 log10 compared to baseline and ALT normalization, at month 1, 2 and 3, and every 3 months after treatment start, and FU month 3, 6, 9 and 12 after EOT., Change of liver elasticity measurement level from baseline compared to the level at every 6 months during on-treatment, EOT, and FU month 6 and 12 after EOT, Percentage of AE of special interest: 1. Liver-related event, defined as new diagnoses of liver cirrhosis, HCC, or hepatic decompensation (ascites, variceal bleeding or hepatic encephalopathy); 2. Event of ≥ grade 3 hematological AE (in IFN treated); 3. Event of thyroid disorder (in IFN treated); 4. Event of injection site reaction; 5. Event of≥ grade 3 ALT increase., Percentage of missed BLV doses during treatment., Percentage of patients with early discontinuation of treatment and the reasons., Percentage of patients with SAE., EXPLORATORY ENDPOINTS: Change of HBcrAg from baseline every 3 months during study period., Change of HBV RNA level from baseline every 3 months during study period., Change of fibrosis stage in pre-treatment liver biopsy, compared to fibrosis stage in on- or post-treatment liver biopsy., Change of inflammation grade in pre-treatment liver biopsy, compared to inflammation grade in on- or post-treatment liver biopsy., Change of quality of life pre-treatment from baseline, compared to every 6 months after treatment start, EOT and FU month 6 and 12., Change of innate or adaptive immunological marker/signature in PBMC from baseline, compared to month 1, 6, and every 6 months, EOT, FU month 6 and 12., Identification of any innate or adaptive immunological marker/signature in PBMC, associated with on- or off-treatment virological and/or biochemical response., Identification of any intrahepatic immune marker/signature in pre-treatment liver biopsy, associated with on-treatment or off-treatment virological and/or biochemical response, Identification of any biomarker in serum, associated with on- or off-treatment virological and/or biochemical response., Identification of any changes in oral or fecal microbiome, or other features in saliva or feces from baseline during and after treatment.

Source: https://euclinicaltrials.eu/ctis-public/view/2023-504414-29-00